EU clinical trial 2024-512053-24-00: A single-arm phase II study of cetuximab plus platinum and taxane-based chemotherapy followed by AVElumab and Cetuximab as first-line therapy for recurrent/metastatic (R/M) head and neck squamous cell carcinoma (HNSCC) patients with PD-L1 combined positive score (CPS)≥1≤19: the immunotherapy.
Protocol code: AVEC-119
Sponsor: Fondazione GONO Plus (Laboratory/Research/Testing facility). Phase: Therapeutic exploratory (Phase II). Countries: Italy (ongoing, recruiting).
Therapeutic area(s): Diseases [C] - Neoplasms [C04]
Gender: Female, Male. Age: 18-64 years, 65+ years. Enrolment: 67.
Status: Ongoing, recruiting. Start date (EU): 2024-12-05. Decision date: 2024-10-09. Results received: No. Last updated: 2026-04-30.

Condition(s): recurrent/metastatic (R/M) head and neck squamous cell carcinoma (HNSCC)
Product: AVELUMAB, Erbitux 5 mg/mL solution for infusion

Primary endpoint: To assess 6m-progression free survival (PFS) of cetuximab plus platinum and taxane-based chemotherapy followed by avelumab and cetuximab maintenance
Endpoint(s): To assess overall survival (OS) of cetuximab plus platinum and taxane-based chemotherapy followed by avelumab and cetuximab maintenance, To assess overall response rate (ORR) of cetuximab plus platinum and taxane-based chemotherapy followed by avelumab and cetuximab maintenance, To assess safety of cetuximab plus platinum and taxane-based chemotherapy followed by avelumab and cetuximab maintenance, To assess duration of response (DOR) of cetuximab plus platinum and taxane-based chemotherapy followed by avelumab and cetuximab maintenance, Active autoimmune disease that has required systemic treatment in past 2 years (i.e. with use of disease modifying agents, corticosteroids or immunosuppressive drugs)., Active autoimmune disease that might deteriorate when receiving an immuno-stimulatory agent. Patients with type I diabetes, vitiligo, psoriasis, or hypo- or hyperthyroid diseases not requiring immunosuppressive treatment are eligible., Any diagnosed and/or treated additional malignancy within 5 years before the study entry with the exception of: curatively treated basal cell carcinoma of the skin, curatively treated squamous cell carcinoma of the skin, curatively treated prostate cancer, curatively resected in situ cervical cancer, and curatively resected in situ breast cancer., Subjects with a history or current evidence of any condition, therapy, or laboratory abnormality that might confound the results of the trial, interfere with the subjects’ participation for the full duration of the trial, or is not in the best interest of the subject to participate, according to the opinion of the treating investigator., Significant neurologic or known psychiatric or substance abuse disorders that would interfere with cooperation and the requirements of the trial., Clinically significant (i.e., active) cardiovascular disease: cerebral vascular accident/stroke (≤6 months prior to enrollment), myocardial infarction (≤6 months prior to enrollment), unstable angina, congestive heart failure (≥ New York Heart Association Classification Class II), or serious cardiac arrhythmia requiring medication., Prior organ transplantation including allogenic stem-cell transplantation., Active uncontrolled infection requiring systemic therapy (i.e. I.V. antibiotics)., Known history of testing positive for HIV or known acquired immunodeficiency syndrome., Hepatitis B virus (HBV) or hepatitis C virus (HCV) infection at screening (positive HBV surface antigen or HCV RNA if anti-HCV antibody screening test positive)., Live vaccination within 30 days of planned start of study treatment (inactivated vaccines are allowed)., Pregnancy (absence of pregnancy must be confirmed by negative serum or urine pregnancy test-ß-HCG-for women of childbearing potential) and/or breast-feeding are not allowed. Subjects of childbearing potential willing to use effective contraceptive method [PI<1; e.g. oral contraceptive (pill), hormone spiral, hormone implant, transdermal patch, a combination of two barrier methods (condom and diaphragm), sterilization, sexual abstinence] for the entire study duration and 30 days post-dosing

Source: https://euclinicaltrials.eu/ctis-public/view/2024-512053-24-00